EU clinical trial 2024-513490-45-00: VANCALLO - Prevention of C. difficile infections by oral vancomycin in patients treated for allogeneic hematopoietic stem cell transplantation, a randomized double-blind placebo-controlled trial
Protocol code: APHP210089
Sponsor: Assistance Publique Hopitaux De Paris (Hospital/Clinic/Other health care facility). Phase: Therapeutic confirmatory (Phase III). Countries: France (ongoing, recruiting).
Therapeutic area(s): Diseases [C] - Bacterial Infections and Mycoses [C01]
Gender: Female, Male. Age: 0-17 years, 18-64 years, 65+ years. Enrolment: 336.
Status: Ongoing, recruiting. Start date (EU): 2022-10-27. Decision date: 2024-06-26. Results received: No. Last updated: 2024-06-26.

Condition(s): Patients hospitalized for allogeneic hematopoietic stem cell transplantation
Product: PLACEBO OF VANCOMYCINE = NaCl 0.9% ( oral use ), Vancomycine Viatris 500 mg poudre pour solution pour perfusion

Primary endpoint: Clostridium difficile infection, occurring between inclusion and discharge from hospitalization or the end of treatment with vancomycin or placebo (i.e. after 5 weeks of treatment (W5) if the patient is still hospitalized), defined by diarrhea (> 3 unformed stools/day) with detection of CD (GDH) and free toxin in the stools by enzyme immunoassay without argument for another etiology of diarrhea or existence of pseudomembranous colitis at endoscopy, at colectomy or at autopsy.
Endpoint(s): - Clostridium difficile infection, occurring between inclusion and W12, defined by diarrhea (> 3 unformed stools/day) with detection of CD and free toxin in the stools by immunoenzymatic method without argument for another etiology in diarrhea or presence of pseudomembranous colitis at endoscopy, colectomy or autopsy., - Time between inclusion and Clostridium difficile infection as defined in the primary endpoint, in a maximum window up to W5, - Clostridium difficile infection, occurring between inclusion and discharge from hospitalization or the end of treatment with vancomycin or placebo (i.e. after 5 weeks of treatment (W5) if the patient is still hospitalized), defined by diarrhea (> 3 unformed stools/day) with detection of toxigenic CD by PCR without argument for another etiology of diarrhea or existence of pseudomembranous colitis at endoscopy, colectomy or autopsy., - Risk factors for CD infection: type of packaging, antibiotics received, presence of toxigenic strain on D0 of treatment (D0V), composition of the microbiota, - Severity factors of CD infections occurring during the procedure, - Microbiologically documented bacterial infection(s) (regardless of the infectious source) occurring during treatment with 125 mg of vancomycin (i.e. up to 5 weeks maximum), - Acquisition of rectal carriage of vancomycin-resistant Enterococcus (VRE) between randomization and the end of treatment (discharge from hospitalization or W5 maximum) measured by rectal swab, - Study of the intestinal microbiota at inclusion, during treatment (14 days after initiation of treatment, i.e. W2), at the end of treatment (W5 or before discharge from hospitalization) and remotely (W12) as part of the ancillary study, - Occurrence of nosocomial clusters of CD infection at W12 defined as the occurrence of at least 2 cases of CDI over a period of time defined according to the incidence usually observed in the investigating center, - Occurrence of acute or chronic GVHD grade 2-4 at M12, - Time between inclusion and relapse of the hematological disease, or the date of last news (maximum M12), - Mortality rate linked to the transplant procedure (TRM) at W5, - Delay between inclusion and death, or the date of last news (maximum M12), - Proportion of adverse effects during protocol monitoring

Source: https://euclinicaltrials.eu/ctis-public/view/2024-513490-45-00